EU clinical trial 2024-515610-41-00: A Phase 2, Randomized, Double-Blind, Placebo-Controlled, Parallel-Group, Dose-Finding Study to Evaluate the Safety, Tolerability and Efficacy of AGA2118 in Postmenopausal Women with Low Bone Mineral Density
Protocol code: ACT23-001
Sponsor: Angitia Inc. Ltd. (Pharmaceutical company). Phase: Therapeutic exploratory (Phase II). Countries: Bulgaria (ended), Estonia (ended), Poland (ongoing, recruitment ended), Denmark (ended).
Therapeutic area(s): Diseases [C] - Musculoskeletal Diseases [C05]
Gender: Female. Age: 18-64 years, 65+ years. Enrolment: 260.
Start date (EU): 2025-09-11. Decision date: 2025-01-10. Results received: No. Last updated: 2025-12-23.
Decision dates by country: BG: 2025-01-13, DK: 2025-01-10, EE: 2025-01-10, PL: 2025-01-11

Condition(s): Postmenopausal Osteoporosis
Product: Placebo to match AGA2118, AGA2118

Primary endpoint: Percent change from Baseline to Month 12 in lumbar spine BMD
Endpoint(s): Percent change from Baseline to Months 3 and 6 in lumbar spine, total hip, femoral neck, and one-third distal radius BMD, Percent change from Baseline to Month 12 in total hip, femoral neck, and one-third distal radius BMD, Percent change from Baseline to Months 1, 3, 6, 9, and 12 in [CCI], Incidence of new clinical fractures (vertebral and nonvertebral) between Baseline and Month 12

Source: https://euclinicaltrials.eu/ctis-public/view/2024-515610-41-00